EU clinical trial 2023-509908-15-00: Full title of the clinical trial: A Phase 3 Randomized, Open-Label, Multicenter Study Comparing Zanubrutinib (BGB-3111) plus Rituximab Versus Bendamustine plus Rituximab in Patients with Previously Untreated Mantle Cell Lymphoma Who Are Ineligible for Stem Cell Transplantation
Protocol code: BGB-3111-306
Sponsor: BeOne Medicines AG (Pharmaceutical company). Phase: Phase II and Phase III (Integrated). Countries: Austria (ongoing, recruitment ended), Portugal (ongoing, recruitment ended), Netherlands (ongoing, recruitment ended), Spain (ongoing, recruitment ended), Belgium (ongoing, recruitment ended), Germany (ongoing, recruitment ended), Romania (ongoing, recruitment ended), Poland (ongoing, recruitment ended), Ireland (ongoing, recruitment ended), France (ongoing, recruitment ended), Italy (ongoing, recruitment ended).
Therapeutic area(s): Diseases [C] - Neoplasms [C04]
Gender: Female, Male. Age: 18-64 years, 65+ years. Enrolment: 267.
Status: Ongoing, recruitment ended. Start date (EU): 2020-01-20. Decision date: 2024-05-27. Results received: No. Last updated: 2026-07-20.
Decision dates by country: AT: 2024-05-31, BE: 2024-06-03, FR: 2024-06-12, DE: 2024-05-29, IE: 2024-05-27, IT: 2024-06-18, PT: 2024-05-27, RO: 2024-05-30, ES: 2024-05-30, NL: 2024-05-28, PL: 2024-06-03

Condition(s): Mantle Cell Lymphoma
Product: Zanubrutinib, Bendamustin Hikma 2,5 mg/ml Pulver für ein Konzentrat zur Herstellung einer Infusionslösung, MabThera 100 mg concentrate for solution for infusion, MabThera 500 mg concentrate for solution for infusion, Bendamustin Kabi 2,5 mg/ml Pulver für ein Konzentrat zur Herstellung einer Infusionslösung

Primary endpoint: The primary endpoint is PFS as determined by independent central review using the Lugano Classification for NHL and defined as the time from randomization to the date of first documentation of disease progression or death, whichever occurs first.
Endpoint(s): Progression-free survival as determined by investigator assessment using the Lugano Classification for NHL, and defined as the time from randomization to the date of first documentation of disease progression or death, whichever occurs first, Overall response rate, defined as the proportion of patients who achieve a CR or partial response (PR), determined by independent central review and by investigator assessment, Duration of response, as determined by independent central review and by investigator assessment, and defined as the time from the date that response criteria are first met to the date that disease progression is objectively documented or death, whichever occurs first, Overall survival, defined as the time from randomization to the date of death due to any reason, Rate of CR or complete metabolic response, defined as the proportion of patients who achieve a CR or complete metabolic response, determined by independent central review and by investigator assessment, Time to response, as determined by independent central review and by investigator assessment, and defined as time from randomization to the first documentation of response, Patient-reported outcomes as measured by the EQ-5D-5L and EORTC QLQ-C30 questionnaires, Safety parameters, including AEs, SAEs, clinical laboratory tests, physical exams, and vital signs

Source: https://euclinicaltrials.eu/ctis-public/view/2023-509908-15-00